EU clinical trial 2023-504816-14-00: A Phase 3, Randomized, Active-controlled, Open-label, Multicenter Study to Compare the Efficacy and Safety of MK-2870 Monotherapy Versus Treatment of Physician’s Choice in Participants With Endometrial Cancer Who Have Received Prior Platinum-based Chemotherapy and Immunotherapy (MK-2870-005/ENGOT-en23/GOG-3095)
Protocol code: MK-2870-005
Sponsor: Merck Sharp & Dohme LLC (Pharmaceutical company). Phase: Therapeutic confirmatory (Phase III). Countries: Czechia (ongoing, recruitment ended), France (ongoing, recruitment ended), Ireland (ongoing, recruitment ended), Austria (ongoing, recruitment ended), Denmark (ended), Finland (ongoing, recruitment ended), Greece (ongoing, recruitment ended), Sweden (ongoing, recruitment ended), Netherlands (ongoing, recruitment ended), Italy (ongoing, recruitment ended), Spain (ongoing, recruitment ended), Belgium (ongoing, recruitment ended), Poland (ongoing, recruitment ended), Norway (ongoing, recruitment ended), Germany (ongoing, recruitment ended).
Therapeutic area(s): Diseases [C] - Neoplasms [C04]
Gender: Female. Age: 18-64 years, 65+ years. Enrolment: 378.
Start date (EU): 2024-03-08. Decision date: 2024-02-26. Results received: No. Last updated: 2026-07-31.
Decision dates by country: NL: 2024-04-22, NO: 2024-02-26, AT: 2024-02-28, BE: 2024-04-17, FI: 2024-02-28, SE: 2024-02-27, ES: 2024-04-11, DK: 2024-02-28, CZ: 2024-02-26, IE: 2024-03-01, IT: 2024-04-22, DE: 2024-04-24, PL: 2024-02-29, GR: 2024-03-04, FR: 2024-02-28

Condition(s): Endometrial cancer
Product: PACLITAXEL ALBUMIN-BOUND, DOXORUBICIN, PARACETAMOL, COMBINATIONS EXCL. PSYCHOLEPTICS, MK-2870, MK-2870, PACLITAXEL

Primary endpoint: Progression free Survival (PFS) per Response Evaluation Criteria in Solid Tumors (RECIST) 1.1 as Assessed by Blinded Independent Central Review (BICR), Overall Survival (OS)
Endpoint(s): Objective Response Rate (ORR) per RECIST 1.1 as Assessed by BICR, Duration of Response (DOR) per RECIST 1.1 as Assessed by BICR, Number of Participants Who Experience One or More Adverse Events (AEs), Number of Participants Who Discontinue Study Intervention Due to an AE, Change from Baseline in Global Health Status/Quality of Life Score (European Organisation for Research and Treatment of Cancer Quality-of-Life Questionnaire Core 30 [EORTC QLQ-C30]

Source: https://euclinicaltrials.eu/ctis-public/view/2023-504816-14-00